EU clinical trial 2022-500069-29-00: A phase 1b/2, multicenter, adaptive, double-blind, randomized, placebo-controlled study to assess the safety, tolerability, immunogenicity, and pharmacodynamic effects of ACI-24.060 in subjects with prodromal Alzheimer’s disease and in adults with Down syndrome (ABATE)
Protocol code: ACI-24-AD-DS-2102
Sponsor: AC Immune S.A. (Pharmaceutical company). Phase: Phase I and Phase II (Integrated)- Other. Countries: Spain (ongoing, recruiting).
Therapeutic area(s): Psychiatry and Psychology [F] - Mental Disorders [F03]
Gender: Female, Male. Age: 18-64 years, 65+ years. Enrolment: 75.
Status: Ongoing, recruiting. Start date (EU): 2022-11-02. Decision date: 2022-08-04. Results received: No. Last updated: 2026-07-17.

Condition(s): Alzheimer's disease
Product: Neuraceq 300 MBq/mL solution for injection, [18F]PI-2620, ACI-24.060, Placebo

Primary endpoint: Safety and Tolerability: Adverse events (AEs); physical and neurological examination results; global assessment of tolerability; vital signs; brain MRI assessment; electrocardiogram (ECG); routine hematology and biochemistry evaluation in blood and urine; inflammatory and autoimmune markers in blood and CSF; suicidality as measured with Columbia-Suicide Severity Rating Scale (C-SSRS).
Endpoint(s): Pharmacodynamic (Immunogenicity): Anti-Aβ antibody titers in serum (eg, geometric mean of antibody titers, change from baseline, responder rate, peak, and area under the curve [AUC]).

Source: https://euclinicaltrials.eu/ctis-public/view/2022-500069-29-00